EU clinical trial 2023-505200-33-00: C1071015 - ELRANATAMAB POST TRIAL ACCESS: AN OPEN-LABEL, SINGLE-ARM STUDY FOR PARTICIPANTS WITH MULTIPLE MYELOMA CONTINUING FROM PFIZER-SPONSORED ELRANATAMAB CLINICAL STUDIES
Protocol code: C1071015
Sponsor: Pfizer Inc. (Pharmaceutical company). Phase: Therapeutic confirmatory (Phase III). Countries: France (authorised, recruitment pending), Spain (ongoing, recruiting), Germany (ended).
Therapeutic area(s): Diseases [C] - Hemic and Lymphatic Diseases [C15]
Gender: Female, Male. Age: 18-64 years, 65+ years. Enrolment: 14.
Start date (EU): 2026-06-15. Decision date: 2023-11-15. Results received: No. Last updated: 2026-01-26.
Decision dates by country: DE: 2023-11-16, ES: 2023-11-16, FR: 2023-11-15

Condition(s): Multiple myeloma
Product: ELRANATAMAB

Primary endpoint: Nonserious adverse events (AEs) leading to permanent discontinuation of elranatamab, All Serious Adverse Event (SAEs)

Source: https://euclinicaltrials.eu/ctis-public/view/2023-505200-33-00